EU clinical trial 2024-515555-38-01: A Phase II, Open-Label, Single Arm, prospective, multicenter study of niraparib plus dostarlimab in patients with pleural mesothelioma positive for PD-L1 expression and germline or somatic mutations in the HRR genes
Protocol code: UNITO-001
Sponsor: Universita' Degli Studi Di Torino (Educational Institution). Phase: Therapeutic exploratory (Phase II). Countries: Italy (authorised, recruitment pending).
Therapeutic area(s): Diseases [C] - Neoplasms [C04]; Diseases [C] - Respiratory Tract Diseases [C08]
Gender: Female, Male. Age: 18-64 years, 65+ years. Enrolment: 48.
Status: Authorised, recruitment pending. Decision date: 2024-12-09. Results received: No. Last updated: 2026-05-22.

Condition(s): NON SMALL CELL LUNG CANCER, PLEURAL MESOTHELIOMA
Product: NIRAPARIB, JEMPERLI 500 mg concentrate for solution for infusion

Primary endpoint: To evaluate the progression free survival (PFS)
Endpoint(s): To evaluate the objective response rate (ORR) To evaluate the duration of response (DOR) To evaluate the disease control rate (DCR) To evaluate the overall survival (OS) To evaluate the safety and tolerability of the combination of Niraparib and dostarlimab

Source: https://euclinicaltrials.eu/ctis-public/view/2024-515555-38-01